EU clinical trial 2025-522542-40-00: TENACITY – A Phase III, prospective, randomized, open-label, blinded endpoint assessment (PROBE) to assess efficacy and safety of i.v. tenecteplase vs standard of care in patients with acute ischemic stroke (including wake-up stroke), last known well >4.5 h with imaging evidence of salvageable ischemic tissue
Protocol code: 1123-0060
Sponsor: Boehringer Ingelheim International GmbH (Pharmaceutical company). Phase: Therapeutic confirmatory (Phase III). Countries: Greece (ongoing, recruiting), Norway (authorised, recruitment pending), Hungary (ongoing, recruiting), Romania (ongoing, recruiting), Spain (ongoing, recruiting), Bulgaria (ongoing, recruiting).
Therapeutic area(s): Diseases [C] - Cardiovascular Diseases [C14]
Gender: Female, Male. Age: 18-64 years, 65+ years. Enrolment: 350.
Start date (EU): 2026-06-19. Decision date: 2026-03-11. Results received: No. Last updated: 2026-08-03.
Decision dates by country: HU: 2026-03-12, NO: 2026-03-16, RO: 2026-03-17, ES: 2026-03-11, BG: 2026-03-13, GR: 2026-03-11

Condition(s): Acute Ischemic Stroke
Product: Metalyse 5 000 units (25 mg) powder for solution for injection

Primary endpoint: mRS 0-1 at Day 90
Endpoint(s): mRS (ordinal) at Day 90, Early neurological improvement (reduction in acute – 24-hour NIHSS score of ≥8 or value of 0/1), mRS 0-2 at Day 90, sICH as defined by SITS-MOST criteria at 36 h, sICH as defined by ECASS III criteria at 36 h, Death from any cause within 90 days

Source: https://euclinicaltrials.eu/ctis-public/view/2025-522542-40-00